EU clinical trial 2024-519188-17-00: A Phase 1/1b Study of IAM1363 in HER2 Cancers
Protocol code: IAM1363-01
Sponsor: Iambic Therapeutics Inc. (Pharmaceutical company). Phase: Human Pharmacology (Phase I)- First administration to humans. Countries: Spain (ongoing, recruiting), France (ongoing, recruiting), Ireland (ongoing, recruiting), Italy (authorised, recruiting), Netherlands (ongoing, recruiting).
Therapeutic area(s): Diseases [C] - Neoplasms [C04]
Gender: Female, Male. Age: 18-64 years, 65+ years. Enrolment: 98.
Start date (EU): 2025-10-07. Decision date: 2025-09-11. Results received: No. Last updated: 2026-07-29.
Decision dates by country: FR: 2025-09-11, IE: 2025-09-12, ES: 2025-09-11, NL: 2025-09-12, IT: 2025-09-15

Condition(s): Relapsed/refractory malignancy with documented diagnosis of human epidermal growth factor receptor 2 (HER2) alterations

Source: https://euclinicaltrials.eu/ctis-public/view/2024-519188-17-00